EU clinical trial 2022-503053-19-00: A clinical study investigating OM-85-IN safety and tolerability in healthy volunteers and mild allergic asthma patients
Protocol code: BV-2022/11
Sponsor: OM Pharma S.A. (Pharmaceutical company). Phase: Human Pharmacology (Phase I)- First administration to humans. Countries: Germany (ended).
Therapeutic area(s): Diseases [C] - Respiratory Tract Diseases [C08]
Gender: Female, Male. Age: 18-64 years. Enrolment: 41.
Status: Ended. Start date (EU): 2024-06-14. End date (EU): 2025-02-19. End date: 2025-02-20. Decision date: 2023-10-17. Results received: No. Last updated: 2024-10-17.

Condition(s): Mild allergic asthma

Source: https://euclinicaltrials.eu/ctis-public/view/2022-503053-19-00